EU clinical trial 2025-523193-16-00: A study in healthy men to test how bosentan influences the amount of zongertinib in the blood
Protocol code: 1479-0047
Sponsor: Boehringer Ingelheim International GmbH (Pharmaceutical company). Phase: Human Pharmacology (Phase I)- Other. Countries: Germany (ongoing, recruiting).
Therapeutic area(s): Not possible to specify
Gender: Male. Age: 18-64 years. Enrolment: 16.
Status: Ongoing, recruiting. Start date (EU): 2026-06-16. Decision date: 2026-04-15. Results received: No. Last updated: 2026-04-15.

Condition(s): Healthy volunteer trial

Source: https://euclinicaltrials.eu/ctis-public/view/2025-523193-16-00